EU clinical trial 2024-512296-13-00: A First-In-Human Trial of the novel T cell Immunotherapy pTTL in Patients with Advanced Colorectal Cancer
Protocol code: NEOGAP-CRC-01
Sponsor: NEOGAP Therapeutics AB (Pharmaceutical company). Phase: Human Pharmacology (Phase I)- First administration to humans. Countries: Sweden (ongoing, recruitment ended).
Therapeutic area(s): Diseases [C] - Neoplasms [C04]
Gender: Female, Male. Age: 18-64 years, 65+ years. Enrolment: 16.
Status: Ongoing, recruitment ended. Start date (EU): 2023-04-03. Decision date: 2024-09-05. Results received: No. Last updated: 2026-07-02.

Condition(s): colorectal cancer

Source: https://euclinicaltrials.eu/ctis-public/view/2024-512296-13-00